EU clinical trial 2023-506102-39-00: Watch-and-wait strategy to initiate Dostarlimab-based Immunotherapy in localized deficient mismatch repair (dMMR) and/or microsatellite instability high (MSI-H) oEso-gastric junction and gastric adenocarcinoma: A two cohort open-label GERCOR phase II study
Protocol code: DEWI G-123
Sponsor: Gercor (Pharmaceutical company). Phase: Therapeutic exploratory (Phase II). Countries: France (ongoing, recruiting), Italy (ongoing, recruiting).
Therapeutic area(s): Diseases [C] - Digestive System Diseases [C06]
Gender: Female, Male. Age: 18-64 years, 65+ years. Enrolment: 119.
Status: Ongoing, recruiting. Start date (EU): 2023-12-18. Decision date: 2023-10-20. Results received: No. Last updated: 2026-07-22.
Decision dates by country: IT: 2024-12-04, FR: 2023-10-20

Condition(s): metastatic gastric cancer
Product: JEMPERLI 500 mg concentrate for solution for infusion

Primary endpoint: The rate of patients who achieve cCR at 1 year from the start of treatment with dostarlimab.
Endpoint(s): The number of patients who did not undergo surgery for tumor resection without distant metastases at specific time points (12 months and 24 months),, The number of patients who did not undergo surgery for tumor resection with distant metastases at specific time points (12 and 24 months),, Pathological response (Tumor regression grade by Becker classification) on surgical specimen, when surgery performed for tumor resection,, EFS, TTF, and OS for the whole population, DFS in case of surgery for tumor resection with and without adjuvant treatment with dostarlimab,, The safety of dostarlimab by the NCI CTCAE v 5.0,, Morbidity in case of surgery (complication or death occurring within 90 postoperative days according to the Clavien Dindo’s classification),, HRQoL by the EORTC QLQ-C30 and EORTC QLQ-OG25 questionnaires in patients with or without surgery., The efficacy of dostarlimab according to selected tumor biomarkers: - PD-1 and PD-L1 expression, - CD3+, CD8+, and FOXP3, and inflammatory signature upon RNAseq, Association of PD-L1, PD-1, anti-CTL4, TIM-3, LAG-3, GAL9, IDO, and TIGIT expression to patients’ response,, The prognostic and predictive value of ctDNA presence, at baseline and during follow up,, Prognostic value of dMMR/MSI-H Lynch versus sporadic tumors (Lynch syndrome defined as germline mutations in the mismatch repair genes and sporadic cases as those without germline mutation, without MLH1 mutation in IHC, and with hMLH1 promoter hypermethylation.

Source: https://euclinicaltrials.eu/ctis-public/view/2023-506102-39-00